EU clinical trial 2023-505144-19-00: A prospective, multicentre open-label clinical trial to evaluate the efficacy of the fixed-dose combination of Doxylamine and Pyridoxine 10/10 mg modified-release capsules on the quality of life of pregnant women presenting with nausea and vomiting of pregnancy (NVP).
Protocol code: RES-6131-C1
Sponsor: Itf Research Pharma S.L. (Pharmaceutical company). Phase: Therapeutic use (Phase IV). Countries: Spain (ended).
Therapeutic area(s): Diseases [C] - Digestive System Diseases [C06]
Gender: Female. Age: 18-64 years. Enrolment: 80.
Status: Ended. Start date (EU): 2023-10-31. End date (EU): 2024-08-13. Decision date: 2023-09-12. Results received: Yes. Last updated: 2024-05-10.

Condition(s): Nausea and vomiting of pregnancy
Product: Cariban 10 mg/10 mg cápsulas duras de liberación modificada

Primary endpoint: Difference in results in the global score of the NVPQoL scale after 14 days of treatment with Doxylamine/Pyridoxine 10/10 mg modified-release capsules versus baseline.
Endpoint(s): Difference in results versus baseline, after 7 days of treatment with Doxylamine/Pyridoxine 10/10 mg modified release capsules in the NVPQoL score. The overall score will be evaluated., Difference in results between 7 and 14 days of treatment with Doxylamine/Pyridoxine 10/10 mg modified-release capsules in the NVPQoL score. The overall score will be evaluated., Evolution of nausea and vomiting during treatment with the fixed combination of Doxylamine/Pyridoxine 10/10 mg capsules. The evolution will be evaluated daily against baseline, as well as between 7 and 14 days of treatment by: • PUQE-24 global score • Frequency and score of the individual items of the PUQE-24 scale: nausea, vomiting and retching • Frequency of subjects without NVP (PUQE-24=3), with NVP mild intensity (PUQE-24=4-6), moderate (PUQE-24=7-12) or severe (PUQE-24=13-15)., Frequency of maximum treatment guidelines reached after 14 days of treatment, according to the titration reflected in the summary of product characteristics of the investigational product (morning-afternoon-night posology: 0-0-2, 1-0-2, or 1-1-2) and time taken to achieve the maximum regimen., Time of onset and duration of perceived effect (hours) after taking the first dose (Day 1) of the fixed combination of Doxylamine/Pyridoxine 10/10 mg modified-release capsules, assessed by questionnaire to the patient., Safety, through the incidence of adverse events and serious adverse events during the study period., Degree of therapeutic compliance categorized as poor (<50%), moderate (≥50% to <75%), good (≥75% to <90%) and very good (≥90%), per patient, and by regimen, after 14 days of treatment, obtained by evaluation of excess medication according to the regimen used during the 14 days of treatment., Degree of patient satisfaction, categorized as excellent, very good, good, fair, bad and not evaluated after 14 days of administration., Degree of satisfaction of the investigator, defined in the same way as criterion 8., The profile of the patient (sociodemographic and baseline clinical characteristics) will also be described according to the maximum pattern reached.

Source: https://euclinicaltrials.eu/ctis-public/view/2023-505144-19-00